EU clinical trial 2024-516400-42-00: Bioequivalence of Linagliptin 5 mg Film-Coated Tablets in Healthy Participants Under Fasting Conditions
Protocol code: BLCL-LIN-EU-01
Sponsor: Tecnimede-Sociedade Tecnico-Medicinal S.A. (Pharmaceutical company). Phase: Human Pharmacology (Phase I)- Bioequivalence Study. Countries: Portugal (ended).
Therapeutic area(s): Not possible to specify
Gender: Female, Male. Age: 18-64 years. Enrolment: 42.
Status: Ended. Start date (EU): 2024-10-02. End date (EU): 2024-12-10. Decision date: 2024-09-27. Results received: No. Last updated: 2024-09-27.

Condition(s): No medical condition.

Source: https://euclinicaltrials.eu/ctis-public/view/2024-516400-42-00